EU clinical trial 2025-524240-35-00: OFA-VATS : Impact of opioid free anesthesia on postoperative quality of recovery and analgesia after video or robot assisted thoracic surgery
Protocol code: 35RC23_8812_OFA-VATS
Sponsor: Centre Hospitalier Universitaire De Rennes (Hospital/Clinic/Other health care facility). Phase: Phase III and phase IV (Integrated). Countries: France (authorised, recruitment pending).
Therapeutic area(s): Analytical, Diagnostic and Therapeutic Techniques and Equipment [E] - Anesthesia and Analgesia [E03]
Gender: Female, Male. Age: 18-64 years, 65+ years. Enrolment: 176.
Status: Authorised, recruitment pending. Decision date: 2026-06-05. Results received: No. Last updated: 2026-06-05.

Condition(s): indication for pulmonary resection surgery (segmentectomy or lobectomy), video-assisted thoracoscopy or scheduled robot-assisted surgery.
Product: SUFENTANIL, DEXMEDETOMIDINE, REMIFENTANIL

Primary endpoint: Score obtained from the self-administered QoR-15 questionnaire at D1 after surgery. The questionnaire will be completed by the patient while blinded to the treatment group
Endpoint(s): QoR-15 self-administered questionnaire score on postoperative day 0 (POD0) and postoperative day 1 (POD1), Pain assessed using a standard Numeric Rating Scale (NRS) at rest and during coughing on POD0 (post-intervention), POD1, and POD2, Total dose of morphine administered postoperatively up to POD2, • Number of episodes of postoperative nausea and vomiting (PONV) requiring treatment up to POD2. • Time to return of bowel function (first postoperative flatus), censored at POD2. • Occurrence of postoperative cognitive dysfunction assessed on POD1 using the CAM (Confusion Assessment Method) or CAM-ICU validated in French., Occurrence of postoperative pulmonary complications according to the Melbourne Group Scale (≥4 of 8 criteria)) within 28 days after surgery, • Forced Expiratory Volume per second (FEV₁) measured preoperatively (day −1) and on POD1 using a portable electronic spirometer. • Peak Expiratory Flow (PEF) measured preoperatively (day −1) and on POD1 using a portable electronic spirometer. • Forced Vital Capacity (FVC) measured preoperatively (day −1) and on POD1 using a portable electronic spirometer • Duration of postoperative oxygen therapy within the first 72 postoperative hours, Time to first patient mobilization (ambulation), censored at 28 days, Total length of hospital stay, censored at 28 days, Mortality at POD28, • Number of patients with chronic pain at 6 months postoperatively, assessed using a simplified DN4 questionnaire by telephone interview (DN2). DN2 considered positive if ≥3 positive answers out of 7. DN4 questionnaire considered positive if ≥4 positive answers out of 10. • Pain intensity assessed using the Numeric Rating Scale (NRS) at rest and during coughing at 6 months by telephone interview. • Analgesic consumption, including opioids, Occurrence of intraoperative cardiac events, including bradycardia (defined as episodes with heart rate <45 beats/min), hypotension (defined as mean arterial pressure <65 mmHg), and hypertension (defined as mean arterial pressure >90 mmHg)

Source: https://euclinicaltrials.eu/ctis-public/view/2025-524240-35-00